EU clinical trial 2024-514067-25-00: A study to evaluate the safety and tolerability of JNJ-70035108 and to evaluate how long JNJ-70035108 stays in and acts on the body (pharmacokinetics) when given as single and repeated doses to healthy participants
Protocol code: 70035108EDI1001
Sponsor: Janssen Cilag International (Pharmaceutical company). Phase: Human Pharmacology (Phase I)- First administration to humans. Countries: Belgium (ended).
Therapeutic area(s): Diseases [C] - Immune System Diseases [C20]
Gender: Female, Male. Age: 18-64 years, 65+ years. Enrolment: 99.
Status: Ended. Start date (EU): 2024-09-23. End date (EU): 2025-03-10. Decision date: 2024-09-10. Results received: No. Last updated: 2024-09-25.

Condition(s): Inflammatory Conditions

Source: https://euclinicaltrials.eu/ctis-public/view/2024-514067-25-00